EU clinical trial 2024-520407-27-00: APOLLO: A Randomized, Double-Blind, Placebo-Controlled Study of Bitopertin to Evaluate the Efficacy, Safety, and Tolerability in Participants with Erythropoietic Protoporphyria (EPP) or X-Linked Protoporphyria (XLP)
Protocol code: DISC-1459-301
Sponsor: Disc Medicine Inc. (Pharmaceutical company). Phase: Therapeutic confirmatory (Phase III). Countries: Germany (ended), Ireland (ongoing, recruitment ended), Spain (ended), France (ended), Norway (ended), Netherlands (ended), Sweden (ongoing, recruitment ended), Belgium (ongoing, recruitment ended), Italy (ongoing, recruitment ended).
Therapeutic area(s): Diseases [C] - Nutritional and Metabolic Diseases [C18]
Gender: Female, Male. Age: 0-17 years, 18-64 years, 65+ years. Enrolment: 71.
Start date (EU): 2025-10-23. Decision date: 2025-09-29. Results received: No. Last updated: 2026-03-24.
Decision dates by country: IE: 2025-10-03, NL: 2025-09-29, SE: 2025-09-30, NO: 2025-10-10, DE: 2025-10-02, IT: 2025-09-30, FR: 2025-09-29, BE: 2025-11-14, ES: 2025-10-01

Condition(s): X-Linked Protoporphyria (XLP), Erythropoietic Protoporphyria (EPP)
Product: Bitopertin, Matching Placebo

Primary endpoint: Average monthly total time in sunlight on days without pain from a phototoxic reaction between 10:00 to 18:00 (10:00 AM to 6:00 PM) after 6 months (24 weeks) of treatment, Percent change from baseline in whole-blood metal-free PPIX levels at 6 months, Safety and tolerability, as assessed by adverse events (AEs) and laboratory results, over the 6-month treatment period
Endpoint(s): Occurrence of phototoxic reactions over the 6-month treatment period, Cumulative total time in sunlight on days without pain from a phototoxic reaction between 10:00 to 18:00 (10:00 AM to 6:00 PM) over the 6-month (24-week) treatment period, Change from baseline in 2-week average daily sunlight exposure time (minutes) to first prodromal symptom (eg, burning, tingling, itching, or stinging) associated with sunlight exposure between 1 hour post-sunrise and 1 hour pre-sunset at 6 months

Source: https://euclinicaltrials.eu/ctis-public/view/2024-520407-27-00